EU clinical trial 2024-518674-14-00: An Open-Label Study of Mibavademab (REGN4461), a Leptin Receptor Agonist, for the Treatment of Monogenic Obesity Due to Biallelic Loss of Function Variants of the LEP Gene
Protocol code: R4461-MOB-2471
Sponsor: Regeneron Pharmaceuticals Inc. (Pharmaceutical company). Phase: Therapeutic confirmatory (Phase III). Countries: Germany (authorised, recruitment pending).
Therapeutic area(s): Diseases [C] - Hormonal diseases [C19]
Gender: Female, Male. Age: 0-17 years, 18-64 years, 65+ years. Enrolment: 2.
Status: Authorised, recruitment pending. Decision date: 2025-11-06. Results received: No. Last updated: 2025-11-06.

Condition(s): Monogenic obesity
Product: REGN4461 - Mibavademab

Primary endpoint: Percent change in Body Mass Index (BMI) from baseline to week 24.
Endpoint(s): Percent change in BMI from baseline to week 52., Absolute change in BMI from baseline, through week 52., Percent change in body weight from baseline, through week 52., Absolute change in body weight from baseline, through week 52., Change in waist circumference from baseline, through week 52 in participants aged ≥18 years., Change in absolute total fat mass by whole body DXA from baseline, through week 52., Change in percent total fat mass by whole body DXA from baseline, through week 52., Change in absolute regional fat mass by whole body DXA from baseline, through week 52., Change in percent regional fat mass by whole body DXA from baseline, through week 52., Change in scores in the symptoms of hyperphagia questionnaire from baseline, through week 52., Change in scores in the impacts of hyperphagia questionnaire from baseline, through week 52., Change in scores in the hunger questionnaire from baseline, through week 52., Number of treatment-emergent adverse events (TEAEs) through week 65., Severity of TEAEs through week 65., Concentrations of total mibavademab in serum through week 65., Incidence of anti-drug antibody (ADA) to mibavademab through week 65., Titer of ADA to mibavademab through week 65.

Source: https://euclinicaltrials.eu/ctis-public/view/2024-518674-14-00